EU clinical trial 2023-508700-38-00: A Phase I-II, First-in-Human Study of SKB264 in Patients with Locally Advanced Unresectable /Metastatic Solid Tumors Who are Refractory to Available Standard Therapies
Protocol code: KL264-01
Sponsor: Sichuan Kelun-Biotech Biopharmaceutical Co. Ltd. (Pharmaceutical company). Phase: Therapeutic exploratory (Phase II). Countries: Spain (ended), Italy (ended).
Therapeutic area(s): Diseases [C] - Neoplasms [C04]
Gender: Female, Male. Age: 18-64 years, 65+ years. Enrolment: 31.
Status: Ended. End date (EU): 2024-12-10. Decision date: 2024-06-17. Results received: No. Last updated: 2024-06-20.
Decision dates by country: IT: 2024-06-20, ES: 2024-06-17

Condition(s): Metastatic or locally advanced unresectable solid tumors progressing after available standard therapies
Product: CIMETIDINE, ROXATIDINE, FAMOTIDINE, COMBINATIONS, PARACETAMOL, RANITIDINE, NIZATIDINE, SKB264, FAMOTIDINE

Primary endpoint: ORR (the percentage of patients who achieve CR/PR) per RECIST 1.1
Endpoint(s): Percentage of patients with adverse events, serious adverse events DOR.PFS (time frame: baseline to the end of the study).OS (time frame: baseline to the end of the study).Immunogenicity of SKB264.PK parameters for SKB264-ADC, SKB264-TAB, and free KL610023 payload.Levels of TROP2 expression in tumor tissue and correlation of those levels with responses.

Source: https://euclinicaltrials.eu/ctis-public/view/2023-508700-38-00